EU clinical trial 2022-502959-54-00: A Phase 3, Open-Label, Randomized, Multi-Center Study of DZD9008 versus Platinum-Based Doublet Chemotherapy as First-Line Treatment for Patients with Locally Advanced or Metastatic Non-Small Cell Lung Cancer Harboring Epidermal Growth Factor Receptor Exon 20 Insertion Mutation
Protocol code: DZD2022E0005
Sponsor: Dizal Pharmaceutical Co. Ltd. (Pharmaceutical company). Phase: Therapeutic confirmatory (Phase III). Countries: Spain (ongoing, recruitment ended), Poland (ongoing, recruitment ended), France (ongoing, recruitment ended), Italy (ongoing, recruitment ended), Austria (ended), Belgium (ongoing, recruitment ended), Czechia (ongoing, recruitment ended), Germany (ongoing, recruitment ended), Netherlands (ended).
Therapeutic area(s): Phenomena and Processes [G] - Cell Physiological Phenomena [G04]
Gender: Female, Male. Age: 18-64 years, 65+ years. Enrolment: 65.
Start date (EU): 2023-09-26. Decision date: 2023-06-09. Results received: No. Last updated: 2026-06-18.
Decision dates by country: NL: 2025-01-27, AT: 2023-12-28, DE: 2023-12-07, IT: 2023-06-09, ES: 2023-06-09, BE: 2023-12-04, PL: 2023-06-13, FR: 2023-06-09, CZ: 2024-01-11

Condition(s): Locally Advanced or Metastatic Non-Small Cell Lung Cancer Harboring Epidermal Growth Factor Receptor Exon 20 Insertion Mutation
Product: ALIMTA 500 mg powder for concentrate for solution for infusion, Carboplatin Kabi 10 mg/ml Konzentrat zur Herstellung einer Infusionslösung, Carboplatin Hikma 10 mg/ml Konzentrat zur Herstellung einer Infusionslösung, Carboplat onkovis 10 mg/ml Konzentrat zur Herstellung einer Infusionslösung, Sunvozertinib

Primary endpoint: Progression Free Survival (PFS) as assessed by Blinded independent Central Review (BICR) per RECIST 1.1
Endpoint(s): 1. OS (key secondary endpoint); PFS assessed by Investigator assessment per RECIST 1.1; Confirmed ORR, DoR, DCR, and percentage of tumor size change assessed by BICR and Investigator per RECIST 1.1, 2. AE/SAE per CTCAE 5.0; Laboratory test; Vital signs; ECG; ECHO/ MUGA scan; PFT, 3. Plasma concentration of DZD9008 and metabolite(s), Data from this study may form part of a pooled analysis with data from other studies., 4. EGFR Exon20ins mutation status in tumor tissues, and the correlations with clinical efficacy of drugs, 5. EGFR Exon20ins mutation status in plasma ctDNA collected before drug medication, and the correlations with clinical efficacy of drugs

Source: https://euclinicaltrials.eu/ctis-public/view/2022-502959-54-00